EU clinical trial 2022-500013-32-01: Adjuvant mitotane vs. mitotane with cisplatin/etoposide after primary surgical resection of localised adrenocortical carcinoma with high risk of recurrence (ADIUVO-2 Trial): A pragmatic, randomised, low-intervention phase III, clinical trial with an observational arm.
Protocol code: ADIUVO2
Sponsor: Uppsala University Hospital, Universitaetsklinikum Wuerzburg AöR, Azienda Socio Sanitaria Territoriale Degli Spedali Civili Di Brescia, Rigshospitalet, Narodowy Instytut Onkologii Im. Marii Sklodowskiej-Curie Panstwowy Instytut Badawczy, National Institute Of Endocrinology C.I. Parhon, Vall D Hebron Institute Of Oncology, Assistance Publique Hopitaux De Paris, University Hospital Centre Zagreb, Sao Joao University Hospital Center, Amsterdam UMC Stichting (Hospital/Clinic/Other health care facility, Hospital/Clinic/Other health care facility, Hospital/Clinic/Other health care facility, Hospital/Clinic/Other health care facility, Hospital/Clinic/Other health care facility, Laboratory/Research/Testing facility, Laboratory/Research/Testing facility, Hospital/Clinic/Other health care facility, Hospital/Clinic/Other health care facility, Hospital/Clinic/Other health care facility, Patient organisation/association). Phase: Therapeutic confirmatory (Phase III). Countries: Germany (ongoing, recruiting), Sweden (ongoing, recruiting), France (ongoing, recruiting).
Therapeutic area(s): Diseases [C] - Neoplasms [C04]
Gender: Female, Male. Age: 18-64 years, 65+ years. Enrolment: 120.
Status: Ongoing, recruiting. Start date (EU): 2024-07-05. Decision date: 2022-12-19. Results received: No. Last updated: 2026-04-20.
Decision dates by country: FR: 2023-07-21, SE: 2022-12-19, DE: 2022-12-19

Condition(s): Adrenocortical carcinoma
Product: ETOPOSIDE, CISPLATIN, MITOTANE

Primary endpoint: RFS will be defined as the time between the date of randomisation until documentation of radiological evidence of local recurrence, radiological evidence of distant recurrence or date of death from any cause, whichever occurs first. Patients will be censored at the date of their last evaluation in which they were known to be alive and recurrence-free, regardless of whether recurrence status was verified during that contact (e.g., phone contact).
Endpoint(s): Overall survival is defined as the time interval between the date of randomisation and the date of death from any cause., Assessment of the effect of serum mitotane levels, disease stage, Ki67 index and status of resection margins on clinical outcomes based on physical examination, complete blood count with differential, serum chemistry profile, endocrine assessment and serum mitotane measurement at baseline and until ACC recurrence. The effect will also be assessed using cross-sectional imaging (CT with contrast medium, MRI) of the chest/abdomen/pelvis or FDG PET-CT every 12 weeks until ACC recurrence., The effect of early vs. late start of adjuvant therapy on clinical outcomes will be assessed in a similar manner as above., Quality of life will be measured at baseline, 6, 12 and 24 weeks after the initiation of adjuvant therapy, after completing the 24m study treatment, and at the end of the 1y active follow-up using a validated quality of life questionnaire (EORTC QLQ-C30)., Serious adverse events, grade 3 and above, will be assessed according to the National Cancer Institute Common Terminology Criteria for Adverse Events (NCI-CTCAE, version 5.0) until one year after end of treatment.

Source: https://euclinicaltrials.eu/ctis-public/view/2022-500013-32-01